EU clinical trial 2022-501396-62-00: AN OPEN-LABEL, RANDOMIZED, PHASE 3 STUDY OF LINVOSELTAMAB (REGN5458; ANTI-BCMA X ANTI-CD3 BISPECIFIC ANTIBODY) VERSUS THE COMBINATION OF ELOTUZUMAB, POMALIDOMIDE, AND DEXAMETHASONE (EPd), IN PATIENTS WITH RELAPSED/REFRACTORY MULTIPLE MYELOMA (LINKER-MM3)
Protocol code: R5458-ONC-2245
Sponsor: Regeneron Pharmaceuticals Inc. (Pharmaceutical company). Phase: Therapeutic confirmatory (Phase III). Countries: France (ongoing, recruitment ended), Poland (ongoing, recruitment ended), Germany (ongoing, recruitment ended), Netherlands (ongoing, recruitment ended), Italy (ongoing, recruitment ended), Belgium (ongoing, recruitment ended), Spain (ongoing, recruitment ended).
Therapeutic area(s): Diseases [C] - Neoplasms [C04]
Gender: Female, Male. Age: 18-64 years, 65+ years. Enrolment: 188.
Status: Ongoing, recruitment ended. Start date (EU): 2023-12-12. Decision date: 2023-09-13. Results received: No. Last updated: 2026-06-29.
Decision dates by country: BE: 2023-09-13, FR: 2023-09-13, DE: 2023-09-15, IT: 2023-09-15, ES: 2023-09-14, NL: 2023-09-14, PL: 2023-09-20

Condition(s): Relapsed Refractory Multiple Myeloma
Product: Dexa 8 mg inject JENAPHARM Injektionslösung, DexaHEXAL 8 mg/2 ml Injektionslösung, Imnovid 2 mg hard capsules, Linvoseltamab, Empliciti 300 mg powder for concentrate for solution for infusion., Dexamethasone 4 mg tablets, Imnovid 3 mg hard capsules, Empliciti 400 mg powder for concentrate for solution for infusion., Linvoseltamab, Imnovid 1 mg hard capsules, Imnovid 4 mg hard capsules

Primary endpoint: Progression Free Survival (PFS) per International Myeloma Working Group (IMWG) response criteria determined by Independent Review Committee (IRC) in CD38 antibody exposed participants
Endpoint(s): PFS per IMWG response criteria, determined by IRC, in all study participants, Objective Response (OR) of complete Response (CR) or better per IMWG response criteria as determined by IRC in CD38 antibody exposed participants, OR of CR or better per IMWG response criteria as determined by IRC in all participants, Overall Survival (OS) in participants previously exposed to CD38 antibodies, OS in all participants, Incidence of minimal residual disease (MRD) negative status in participants previously exposed to CD38 antibodies, Incidence of MRD negative status in all participants, Mean change in the worst pain score measured by Brief Pain Inventory-Short Form (BPI-SF) Item 3 in participants previously exposed to CD38 antibodies, Mean change in the worst pain score measured by BPI-SF Item 3 in all participants, Incidence of treatment emergent adverse events (TEAEs) in participants previously exposed to CD38 antibodies, Incidence TEAEs in all participants, Severity of TEAEs in participants previously exposed to CD38 antibodies, Severity of TEAEs in all participants, Incidence of adverse events of special interest (AESI) in participants previously exposed to CD38 antibodies, Incidence of AESI in all participants, Severity of AESI in participants previously exposed to CD38 antibodies, Severity AESI in all participants, Incidence of Serious Adverse Events (SAE) in participants previously exposed to CD38 antibodies, Incidence of SAE in all participants, Severity of SAE in participants previously exposed to CD38 antibodies, Severity of SAE in all participants, PFS per IMWG response criteria as determined by the investigator in participants previously exposed to CD38 antibodies, PFS per IMWG response criteria as determined by the investigator in all participants, OR of Partial Response (PR) or better per IMWG response criteria as determined by the IRC in CD38 antibody exposed participants, OR of PR or better per IMWG response criteria as determined by the IRC in all participants, OR of Very Good Partial Response (VGPR) or better per IMWG response criteria as determined by IRC in CD38 antibody exposed participants, OR of VGPR or better per IMWG response criteria as determined by IRC in all participants, OR of PR or better per IMWG response criteria as determined by the investigator in participants previously exposed to CD38 antibodies, OR of PR or better per IMWG response criteria as determined by the investigator in all participants, OR of VGPR or better per IMWG response criteria as determined by the investigator in participants previously exposed to CD38 antibodies, OR of VGPR or better per IMWG response criteria as determined by the investigator in all participants, OR of CR or better per IMWG response criteria as determined by the investigator in participants previously exposed to CD38 antibodies, OR of CR or better per IMWG response criteria as determined by the investigator in all participants, Duration of Response (DoR) as per IMWG response criteria as determined by the investigator in participants previously exposed to CD38 antibodies, DoR as per IMWG response criteria as determined by the investigator in all participants, DoR as per IMWG response criteria as determined by the IRC in participants previously exposed to CD38 antibodies, DoR as per IMWG response criteria as determined by the IRC in all participants, Duration of MRD negative status in the bone marrow in participants previously exposed to CD38 antibodies, Duration of MRD negative status in the bone marrow in all participants, Time from randomization to objective response (≥PR) as per IMWG response criteria as determined by the investigator in participants previously exposed to CD38 antibodies, Time from randomization to objective response (≥PR) as per IMWG response criteria as determined by the investigator in all participants, Time from randomization to objective response (≥PR) as per IMWG response criteria as determined by the IRC in participants previously exposed to CD38 antibodies, Time from randomization to objective response (≥PR) as per IMWG response criteria as determined by the IRC in all participants, Concentration of linvoseltamab in the serum over time in participants previously exposed to CD38 antibodies, Concentration of linvoseltamab in the serum over time in all participants, Incidence of antidrug antibodies (ADAs) in participants previously exposed to CD38 antibodies, Incidence of ADAs in all participants, Titer of ADAs in participants previously exposed to CD38 antibodies, Titer of ADAs in all participants, Incidence of neutralizing antibodies (Nabs) to linvoseltamab over time in participants previously exposed to CD38 antibodies, Incidence of Nabs to linvoseltamab over time in all participants, Proportion of Pain Responders in participants previously exposed to CD38 antibodies, Proportion of Pain Responders in all participants, Change in patient-reported global health status/quality of life (QoL), per European Organization for Research and Treatment of Cancer Quality of Life Questionnaire (EORTC QLQ-C30) in participants previously exposed to CD38 antibodies, Change in patient-reported QoL, per EORTC QLQ-C30 in all participants, Change in patient reported disease symptoms per EORTC Quality of Life Questionnaire-Multiple Myeloma (MM) module 20 [QLQ-MY20]) in participants previously exposed to CD38 antibodies, Change in patient reported disease symptoms per EORTC QLQ-MY20 in all participants, Patient-Reported Outcomes in Patient Global Impression of Symptom Severity (PGIS) in participants previously exposed to CD38 antibodies, Patient-Reported Outcomes in PGIS in all participants, Patient-Reported Outcomes in Patient Global Impression of Change (PGIC) in participants previously exposed to CD38 antibodies, Patient-Reported Outcomes in PGIC in all participants, Change in patient-reported general health status per EuroQoL-5 Dimension-5 Level Scale [EQ-5D-5L]) in participants previously exposed to CD38 antibodies, Change in patient-reported general health status per EQ-5D-5L in all participants

Source: https://euclinicaltrials.eu/ctis-public/view/2022-501396-62-00